EU clinical trial 2023-505317-25-00: FAPi-PET imaging of in vivo early fistula healing in perianal Crohn’s disease: PERSIST study
Protocol code: NL53558.018.22
Sponsor: Amsterdam UMC (Hospital/Clinic/Other health care facility). Phase: Therapeutic use (Phase IV). Countries: Netherlands (ongoing, recruiting).
Therapeutic area(s): Diseases [C] - Digestive System Diseases [C06]; Analytical, Diagnostic and Therapeutic Techniques and Equipment [E] - Investigative Techniques [E05]
Gender: Female, Male. Age: 18-64 years. Enrolment: 10.
Status: Ongoing, recruiting. Start date (EU): 2023-11-24. Decision date: 2023-07-28. Results received: No. Last updated: 2024-06-24.

Condition(s): perianal Crohn's fistula
Product: GALLIUM (68GA) CHLORIDE

Primary endpoint: - Visual and quantitative 68Ga-FAPi-46 uptake measurements in and around the perianal fistula at baseline, at follow-up (T1) and the change over both time points
Endpoint(s): - The best fitting kinetic model to quantify 68Ga-FAPi-46 pharmacokinetics and tracer uptake., - The most suitable simplified quantitative measurement as a surrogate for the full kinetic model., - The most simplified imaging procedure providing the quantitative measurement correlating to the full kinetic model., - Correlate visual and quantitative 68Ga-FAPi-46 uptake measurements in and around the perianal fistula at baseline, at follow-up (week 2 or week 6 or combined) and the change over both time points with clinical and/or radiological response assessments mid- and end-of-treatment (i.e. week 9 and week 26, respectively)., - Correlate visual and quantitative 68Ga-FAPi-46 uptake measurements in and around the perianal fistula at baseline with clinical and MRI (and eventual endoscopy and pathology if available) parameters at baseline.

Source: https://euclinicaltrials.eu/ctis-public/view/2023-505317-25-00